EU clinical trial 2022-502484-38-00: A 40-week study comparing the efficacy and safety of once weekly IcoSema and daily insulin glargine 100 units/mL in participants with type 2 diabetes inadequately controlled on oral anti diabetic drugs. COMBINE 4
Protocol code: NN1535-4988
Sponsor: Novo Nordisk A/S (Pharmaceutical company). Phase: Therapeutic confirmatory (Phase III). Countries: Greece (ended), Italy (ended), Poland (ended).
Therapeutic area(s): Diseases [C] - Nutritional and Metabolic Diseases [C18]
Gender: Female, Male. Age: 18-64 years, 65+ years. Enrolment: 136.
Status: Ended. Start date (EU): 2024-02-07. End date (EU): 2025-06-25. End date: 2025-07-08. Decision date: 2023-10-03. Results received: Yes. Last updated: 2026-01-30.
Decision dates by country: IT: 2023-10-05, GR: 2023-10-03, PL: 2023-10-09

Condition(s): Type 2 diabetes
Product: IcoSema 700 U/mL + 2 mg/mL PDS290, Lantus SoloStar 100 units/ml solution for injection in a pre-filled pen, DAPAGLIFLOZIN, METFORMIN, PIOGLITAZONE

Primary endpoint: Change in HbA1c. From baseline week 0 (V2) to week 40 (V42)
Endpoint(s): Change in body weight. From baseline week 0 (V2) to week 40 (V42), Time in range 3.9‑10.0 mmol/L (70‑180 mg/dL) using continuous glucose monitoring (CGM) system, Dexcom G6. From week 36 (V38) to week 40 (V42), Time spent < 3.0 mmol/L (54 mg/dL) using continuous glucose monitoring (CGM) system, Dexcom G6. From week 36 (V38) to week 40 (V42), Time spent > 10.0 mmol/L (180 mg/dL) using continuous glucose monitoring (CGM) system, Dexcom G6. From week 36 (V38) to week 40 (V42), Weekly basal insulin dose. From week 38 (V40) to week 40 (V42), Change in Diabetes Treatment Satisfaction Questionnaire (DTSQs) in total treatment satisfaction. From baseline week 0 (V2) to week 40 (V42), Number of clinically significant hypoglycaemic episodes (level 2) (<3.0 mmol/L (54 mg/dL), confirmed by BG meter) or severe hypoglycaemic episodes (level 3). From baseline week 0 (V2) to week 45 (V44), Number of clinically significant hypoglycaemic episodes (level 2) (<3.0 mmol/L (54 mg/dL), confirmed by BG meter). From baseline week 0 (V2) to week 45 (V44), Number of severe hypoglycaemic episodes (level 3). From baseline week 0 (V2) to week 45 (V44), Change in fasting plasma glucose (FPG). From baseline week 0 (V2) to week 40 (V42)

Source: https://euclinicaltrials.eu/ctis-public/view/2022-502484-38-00